EU clinical trial 2023-504940-32-00: A Phase 2, Multicenter, Open-Label Study of DKN-01 in Combination with Tislelizumab ± Chemotherapy as First-Line or Second-Line Therapy in Adult Patients with Inoperable, Locally Advanced or Metastatic Gastric or Gastroesophageal Junction Adenocarcinoma (DisTinGuish)
Protocol code: DEK-DKK1-P205
Sponsor: Leap Therapeutics Inc. (Pharmaceutical company). Phase: Therapeutic exploratory (Phase II). Countries: Germany (ended).
Therapeutic area(s): Diseases [C] - Neoplasms [C04]
Gender: Female, Male. Age: 18-64 years, 65+ years. Enrolment: 15.
Status: Ended. Start date (EU): 2023-10-13. End date (EU): 2025-02-17. End date: 2025-04-21. Decision date: 2023-07-31. Results received: Yes. Last updated: 2024-09-26.

Condition(s): Gastric cancer, Gastric Adenocarcinoma, GastroEsophageal Cancer
Product: FOLINATO CÁLCICO NORMON 350 mg Polvo para solución inyectable EFG., Tislelizumab, DKN-01, Capecitabine Dr. Reddy’s 500 mg Film-Coated Tablets, 5-FU medac 50 mg/ml, Injektionslösung, Oxaliplatin 5mg/ml concentrate for solution for infusion

Primary endpoint: Part A & B: Incidence of TEAEs, Grade ≥3 TEAEs, treatment-related TEAEs, treatment-emergent serious adverse events (TESAEs), treatment-related TESAEs, and TEAEs leading to study drug discontinuation., Part C: Progression-free survival (PFS), as determined by the Investigator per RECIST v1.1, of DKN-01 plus tislelizumab + chemotherapy regimen (CAPOX or mFOLFOX6) versus tislelizumab + chemotherapy regimen (CAPOX or mFOLFOX6) in DKK1-high patients.
Endpoint(s): Part A and Part B: ORR (the proportion of patients with best overall response of CR + PR), as assessed by the Investigator, using RECIST v1.1., Part A and Part B: DoR, defined as the time from initial response (CR or PR) until radiographically documented progressive disease or death due to any cause; progressive disease is defined using RECIST v1.1., Part A and Part B: DoCR, defined as the time from initial CR until radiographically documented progressive disease or death due to any cause; progressive disease is defined using RECIST v1.1., Part A & B: PFS, defined as the time from first study drug dose (i.e., C1D1) to first radiographically documented progressive disease, as determined using RECIST v1.1, or death due to any cause., Part A & B: OS, defined as the time from first study drug dose (i.e., C1D1) to death due to any cause., Part A & B: DoCB, defined as the time from the first study drug dose (i.e., C1D1) to the time of progressive disease, as determined using RECIST v1.1, or death due to any cause in patients who had a best overall response of CR, PR, or SD of ≥6 weeks., Part A & B: DCB, defined as DoCB ≥180 days. Patients who have best overall response of PD or those having clinical benefit but DoCB lasting <180 days will be considered as “non-DCB”., Part A & B: DCR (i.e., CR+PR+ SD at ≥6 weeks), as assessed by the Investigator, using RECIST v1.1., Part A & B: TTR, defined as the time from the first dose of study treatment to the assessment date of the BOR of either CR or PR., Part C: PFS, as determined by the Investigator per RECIST v1.1, of DKN-01 plus tislelizumab + chemotherapy reg (CAPOX or mFOLFOX6) versus tislelizumab + chemotherapy regimen (CAPOX or mFOLFOX6) in all patients., ORR, as determined by the Investigator per RECIST v1.1, of DKN-01 plus tislelizumab + chemotherapy regimen (CAPOX or mFOLFOX6) versus tislelizumab + chemotherapy regimen (CAPOX or mFOLFOX6) in DKK1-high and all patients., DoR, as determined by the Investigator per RECIST v1.1, of DKN-01 plus tislelizumab + chemotherapy regimen (CAPOX or mFOLFOX6) versus tislelizumab + chemotherapy regimen (CAPOX or mFOLFOX6) in DKK1-high and all patients., OS with DKN-01 plus tislelizumab + chemotherapy regimen (CAPOX or mFOLFOX6) versus tislelizumab + chemotherapy regimen (CAPOX or mFOLFOX6) in DKK1-high and in all patients, Incidence of =Grade 3 treatment-related adverse events (TRAEs).

Source: https://euclinicaltrials.eu/ctis-public/view/2023-504940-32-00